EU clinical trial 2024-514621-29-00: A study to compare how different medicines (rosuvastatin, digoxin, metformin, and furosemide) are handled by the body of healthy people and people with liver cirrhosis
Protocol code: 0352-2189
Sponsor: Boehringer Ingelheim International GmbH (Pharmaceutical company). Phase: Human Pharmacology (Phase I)- Other. Countries: Germany (ended).
Therapeutic area(s): Diseases [C] - Nutritional and Metabolic Diseases [C18]
Gender: Female, Male. Age: 18-64 years, 65+ years. Enrolment: 30.
Status: Ended. Start date (EU): 2023-09-07. End date (EU): 2024-12-30. Decision date: 2024-07-10. Results received: No. Last updated: 2024-07-10.

Condition(s): 1. Patients with compensated liver cirrhosis due to any underlying liver disease with advanced fibrosis (F4) and hepatic impairment that meets the criteria for Child-Pugh A 2. Patients with decompensated liver cirrhosis due to any underlying liver disease with advanced fibrosis (F4) and hepatic impairment that meets the criteria for Child-Pugh B

Source: https://euclinicaltrials.eu/ctis-public/view/2024-514621-29-00